EU clinical trial 2023-510506-41-00: PACCELIO - FDG-PET based small volume accelerated immuno chemoradio-therapy in locally advanced NSCLC
Protocol code: ESR-21-21536
Sponsor: TheraOp gGmbH (Laboratory/Research/Testing facility). Phase: Therapeutic exploratory (Phase II). Countries: Germany (ongoing, recruiting).
Therapeutic area(s): Diseases [C] - Neoplasms [C04]
Gender: Female, Male. Age: 18-64 years, 65+ years. Enrolment: 100.
Status: Ongoing, recruiting. Start date (EU): 2024-04-15. Decision date: 2024-07-30. Results received: No. Last updated: 2026-07-15.

Condition(s): Locally advanced, unresectable non-small-cell lung cancer (NSCLC) (Stage III) with a PD-L1-expression of ≥ 1%
Product: IMFINZI 50 mg/mL concentrate for solution for infusion.

Primary endpoint: Completion rate defined as rate of patients having received: • the prescribed radiotherapy dose ± 2 fractions and, simultaneous platinum-based chemotherapy and, immunotherapy consolidation with durvalumab starting within 42 days after the last dose of chemoradiotherapy and, either at least 3 doses of durvalumab or less than 3 doses of durvalumab in case immunotherapy was permanently discontinued due to documented extrathoracic immune-related toxicity.
Endpoint(s): Safety endpoints: Adverse events grade ≥ 3 (according to NCI CTCAE v5.0), SAEs, unexpected AEs, Efficacy endpoints: • Time to locoregional progression: time from randomization to progression in the primary tumor or any of mediastinal lymph nodes, Time to locoregional in-RT-field progres-sion: time from randomization to progres-sion in primary tumor or mediastinal lymph nodes within the target volume, Time to locoregional out-of-RT-field progression: time from randomization to progression in mediastinal lymph nodes outside the target volume, Time to distant progression: time from randomization to appearance of metasta-ses elsewhere, Progression-free survival (PFS), Overall survival (OS), Objective response rate (ORR) defined as the proportion of randomized patients with best response of complete or partial response, Disease control rate (DCR) defined as the proportion of randomized patients with best response of complete response, partial response, or stable disease, Quality of Life: EORTC QLQ-C30 and QLQ-LC13: Change in symptoms, functioning, and global healthstatus/QoL, Radiotherapy quality: Percentage of patients without major proto-col deviations regarding radiotherapy quality

Source: https://euclinicaltrials.eu/ctis-public/view/2023-510506-41-00